EU clinical trial 2024-515886-33-00: A Phase II, Single-Arm, Open-Label Study to Assess the Efficacy and Safety of Canakinumab for the Treatment of Anemia in Patients with IPSS-R Very Low, Low, or Intermediate Risk Myelodysplastic Syndromes or MDS/MPN CANFIRE Trial
Protocol code: CANFIRE
Sponsor: Universitaet Leipzig (Educational Institution). Phase: Therapeutic exploratory (Phase II). Countries: Germany (ongoing, recruitment ended).
Therapeutic area(s): Not possible to specify
Gender: Female, Male. Age: 18-64 years, 65+ years. Enrolment: 11.
Status: Ongoing, recruitment ended. Start date (EU): 2022-03-23. Decision date: 2024-07-09. Results received: No. Last updated: 2025-08-22.

Condition(s): Lower-risk MDS or MDS/MPN
Product: Ilaris 150 mg/ml solution for injection

Primary endpoint: The primary clinical endpoint “documented achievement of erythroid response (HI-E)” is based on internationally accepted and validated IWG 2018 response criteria and defined as an increase in hemoglobin levels by at least 1.5 g/dL, persistent for at least 8 weeks over the baseline hemoglobin level (mean over 16 weeks prior to inclusion) for NTD patients or no transfusions within a 8 week-window for LTB and HTB (major response), and will be determined after 8 cycles of canakinumab treatment.

Source: https://euclinicaltrials.eu/ctis-public/view/2024-515886-33-00